EU clinical trial 2024-519730-23-00: A Phase 2b, non-randomized, controlled, open-label, extension study to evaluate the persistence of immune response of the adjuvanted RSVPreF3 vaccine and the safety and immunogenicity following revaccination in lung and kidney transplant recipients (≥18 years of age)
Protocol code: 224083
Sponsor: GlaxoSmithKline Biologicals (Pharmaceutical company). Phase: Therapeutic exploratory (Phase II). Countries: Italy (ongoing, recruiting), Germany (authorised, recruitment pending), Spain (ongoing, recruitment ended).
Therapeutic area(s): Diseases [C] - Respiratory Tract Diseases [C08]; Diseases [C] - Virus Diseases [C02]
Gender: Female, Male. Age: 18-64 years, 65+ years. Enrolment: 71.
Start date (EU): 2025-11-10. Decision date: 2025-09-16. Results received: No. Last updated: 2026-05-08.
Decision dates by country: DE: 2025-09-16, ES: 2025-09-17, IT: 2025-09-19

Condition(s): Respiratory Syncytial Virus Infections
Product: Arexvy powder and suspension for suspension for injection Respiratory Syncytial Virus (RSV) vaccine (recombinant, adjuvanted)

Primary endpoint: •RSV-A and RSV-B serum neutralizing titers expressed as GMT at Visit 1 in IC-1 and IC-2 groups. •RSV-A and RSV-B serum neutralizing titers expressed as MGI at Visit 1 in the current study over 30 days post last dose in the parent study in IC-1 and IC-2 groups. •RSV-A and RSV-B serum neutralizing titers expressed as GMT in IC-1 and IC-2 groups at Visit 2 and Visit 3.
Endpoint(s): •RSV-A and RSV-B serum neutralizing titers expressed as group GMT ratio IC-2 over IC-1 at Visit 1., •RSV-A and RSV-B serum neutralizing titers expressed as MGI at Visit 2 and Visit 3 over Visit 1 in IC-1 and IC-2 groups., •RSV-A and RSV-B serum neutralizing titers expressed as MGI at Visit 2 in the RSV-031 study over 30 days post last dose in the parent study in IC-1 and IC-2 groups., Percentage of participants reporting: - each solicited administration site event with onset within 7 days after receiving the re-vaccination dose - each solicited systemic event with onset within 7 days after receiving the re-vaccination dose • unsolicited AEs within 30 days after receiving the re-vaccination dose • any SAEs after receiving the re-vaccination dose up to Visit 3 (Month 6) • related SAEs after receiving the re-vaccination dose up to study end (Month 12), Percentage of participants reporting: -fatal SAEs after receiving the re-vaccination dose of the adjuvanted RSVPreF3 vaccine up to study end (Month 12) -AESIs (AEs specific to kidney and lung SOT patients and pIMDs) after receiving the re-vaccination dose up to study end (Month 12)

Source: https://euclinicaltrials.eu/ctis-public/view/2024-519730-23-00